EU clinical trial 2025-522609-39-00: Antisense Oligonucleotide Eye Drops Against IRS-1 to Treat Pathological Corneal Neovascularisation in Aniridia-Associated Keratopathy (Olisens-Aniridia)
Protocol code: Uni-Koeln-5378
Sponsor: University Of Cologne (Educational Institution). Phase: Therapeutic exploratory (Phase II). Countries: Germany (ongoing, recruiting).
Therapeutic area(s): Diseases [C] - Eye Diseases [C11]
Gender: Female, Male. Age: 0-17 years, 18-64 years, 65+ years. Enrolment: 20.
Status: Ongoing, recruiting. Start date (EU): 2026-05-22. Decision date: 2026-01-23. Results received: No. Last updated: 2026-07-02.

Condition(s): Corneal Neovascularization in Aniridia-associated Keratopathy
Product: OLISENS 0,86 mg/ml, collyre en solution en récipient unidose

Primary endpoint: Relative change of corneal area covered by CoNV assessed by digital standardized slit lamp images and an independent reading center.
Endpoint(s): Visual acuity (BCVA) measured by ETDRS charts (transformed to logMAR), Glare visual acuity measured by ETDRS charts (transformed to logMAR), Vision related quality of life assessed by overall score of NEI-VFQ25 and overall score of Aniridia-Net questionnaire, Intraocular pressure measured by I Care or Goldmann applanation tonometry, reported as mmHg, Ocular Surface Staining measured by Oxford Grading Scale (Grades 0-5), Corneal Sensation measured by length of the nylon monofilament of Cochet-Bonnet esthesiometer when the applied pressure is noticed by the participant, Central Corneal Thickness measured by Scheimpflug Corneal Tomography (Pentacam) or Anterior Segment Optical Coherence Tomography (Casia-2), Vessel Morphometry measured by vessel thickness, vessel length, vessel regression, vessel recurrence, Quality of Life (Ocular Pain) assessed by overall score of Ocular Pain Asessment Survey (OPAS), Aniridia-Associated Keratopathy Grading measured by Lagali Aniridia Associated Kerathopathy Grading, Retinal adverse events (Optical Coherence Tomography), Active infectious keratitis or corneal ulceration assessed by slit lamp examination

Source: https://euclinicaltrials.eu/ctis-public/view/2025-522609-39-00